EU clinical trial 2024-513427-17-00: SHORTEN - Impact of omalizumab withdrawal after a 3 year duration treatment in well controlled severe allergic asthma : a multicentric randomized controlled trial
Protocol code: APHP180614
Sponsor: Assistance Publique Hopitaux De Paris (Hospital/Clinic/Other health care facility). Phase: Therapeutic use (Phase IV). Countries: France (ongoing, recruiting).
Therapeutic area(s): Diseases [C] - Respiratory Tract Diseases [C08]
Gender: Female, Male. Age: 18-64 years, 65+ years. Enrolment: 234.
Status: Ongoing, recruiting. Start date (EU): 2021-05-20. Decision date: 2024-08-28. Results received: No. Last updated: 2026-05-06.

Condition(s): Well controlled severe allergic asthma
Product: Xolair 75 mg solution for injection in pre-filled syringe

Primary endpoint: Number of asthma exacerbations in the year following randomization. An exacerbation is defined as an oral or injectable steroid course for at least 2 days and/or a minimum doubling of the usual steroid dose for at least 2 days for steroid dependent patients.
Endpoint(s): Changes in asthma control test (ACT) at 6 and 12 months. ACT is a five questions self-administered standardized questionnaire. The ACT contains 5 questions that are related to the frequency of both asthma symptoms and required rescue medication use during the previous 4 weeks. The scores in the ACT range from 5 (worse control) to 25 (total control). A minimal change in 5 points for the total score is considered clinically significant., Changes in asthma quality of life (AQLQ) and St. George's Respiratory Questionnaire (SGRQ) at 6 and 12 months., Changes in FEV1 (in ml) at 6 and 12 months to assess respiratory function, Changes in daily oral steroid dose at 6 and 12 months (percentage of variations, proportion of patients increasing their dose by ≥20%, ≥50%, ≥80%), Changes in the number of asthma controller drugs at 6 and 12 months, Changes in the mean daily dose (µg/j) of inhaled steroids received in the 3 previous months at 6 and 12 months, Time to loss of asthma control defined by the number of days between the randomization and the prescription of OMA (in the withdrawal group) or another step 5 asthma treatment (mepolizumab, benralizumab, bronchial thermoplasty...); according to the pulmonologist's choice., Time to exacerbation defined by the number of days between the randomization and the first occurence of an exacerbation. An exacerbation is defined as an oral or injectable steroid course for at least 2 days and/or a minimum doubling of the usual steroid dose for at least 2 days for steroid dependent patients., Number of emergency room visits for asthma in the year following randomization, Number of hospitalisations for asthma in the year following randomization, Occurrence of deterioration of the asthma control (ACT) at 6 and 12 months, defined respectively by an ACT score at 6 and 12 months lower by 5 points or more compared to the ACT score at inclusion, Effect of OMA treatment duration before randomization on asthma control, on time of loss of asthma and on exacerbations. The following categories will be considered: [33-48 months; 49-63 months; more than 63 months], Effect of OMA dosage before randomization on asthma control, on time of loss of asthma and on exacerbations. The following categories will be considered: [150-300 mg/month]; ]300-600 mg/month];]600-900 mg/month] and ]900-1200 mg/month], Effect of OMA eosinophils rate on asthma control, on time of loss of asthma and on exacerbations. The following categories will be considered: <300/mm3;≥300/mm3., Occurence of allergy manifestations (conjunctivitis, rhinitis, atopic dermatitis, food allergy (oral syndrome and anaphylactic reactions)) at 6 and 12 months

Source: https://euclinicaltrials.eu/ctis-public/view/2024-513427-17-00